EU clinical trial 2025-521476-65-00: Optimising TREATment for severe Gram-Negative Bacterial infections.
Protocol code: TREAT-GNB
Sponsor: Fundacion Para La Gestion De La Investigacion En Salud De Sevilla (Laboratory/Research/Testing facility). Phase: Therapeutic use (Phase IV). Countries: Spain (ongoing, recruiting).
Therapeutic area(s): Diseases [C] - Bacterial Infections and Mycoses [C01]
Gender: Female, Male. Age: 18-64 years, 65+ years. Enrolment: 1200.
Status: Ongoing, recruiting. Start date (EU): 2026-05-28. Decision date: 2025-09-09. Results received: No. Last updated: 2026-02-09.
Decision dates by country: ES: 2025-10-13

Condition(s): Severe Gram-Negative Bacterial infections

Source: https://euclinicaltrials.eu/ctis-public/view/2025-521476-65-00